EU clinical trial 2023-505809-17-00: Randomized, multiCentre, dOuble-blind, double-duMmy, parallel-group clinical study on efficacy and safety of iBuprofen/N-acetylcysteine fixed dose cOmbination vs. its individual components (ibuprofen and N- acetylcysteine monotherapies) in patients with symptomatic uncomplicated upper respiratory tract infections with wet cough COMBO
Protocol code: 23CT0001
Sponsor: E Pharma Trento S.p.A. (Pharmaceutical company). Phase: Therapeutic confirmatory (Phase III). Countries: Italy (not authorised).
Therapeutic area(s): Diseases [C] - Respiratory Tract Diseases [C08]
Gender: Female, Male. Age: 18-64 years, 65+ years. Enrolment: 483.
Status: Not authorised. Decision date: 2023-11-09. Results received: No. Last updated: 2023-11-09.

Condition(s): Upper respiratory tract infections
Product: NAXIL 200 mg šumeće tablete, TACHIPIRINA 500 mg compresse, NAC matching-placebo effervescent oral tablets, MOMENTACT ANALGESICO 400 mg granulato per soluzione orale., IBU-matching placebo granules for oral solution in sachets, IBU-NAC

Primary endpoint: Time from randomization to clinically significant improvement of signs and symptoms of uncomplicated URTI with wet cough, defined as a score ≤ 1 on a 5-point Likert scale (range 0-4; 0 = no symptom, 1 = mild symptom 2 = moderate symptom, 3 = severe symptom, 4 = very severe symptom) for each single URTI sign/symptom (i.e. cough, fever [i.e., axillary temperature ≥ 37.5 °C], cold symptoms and a total sum score for all URTI signs and symptoms ≤ 3.
Endpoint(s): Proportion of participants with clinically significant improvement of URTI signs and symptoms at each day up to the end of treatment (EOT) visit (Day 8 ± 1), as defined above, Proportion of participants with resolution of URTI signs and symptoms, defined as a total sum score for all URTI signs and symptoms = 0 on the 5-point Likert scale (range 0-4), at each day up to EOT, Time to resolution of URTI signs and symptoms, Proportion of participants who discontinue early treatment with IMPs due to resolution of URTI signs and symptoms from baseline to EOT, Changes from baseline of the total sum score and individual scores for the severity of URTI signs and symptoms, as well as the Area Under the Curve (AUC) of each URTI sign/symptom score over time, as evaluated on the 5-point Likert scale (range 0-4), Changes from baseline of total and single item scores of the Wisconsin Upper Respiratory Symptoms Survey (WURSS-21), Proportion of participants with reduction of symptom severity to ≤1 for each single item related to the cluster of cold symptoms on the WURSS-21 at EOT, Investigator’s overall assessment of efficacy at EOT and end of study (EOS) visit (Day 15 ± 2) as cure (complete disappearance of signs and symptoms of inflammation), improvement (non-complete resolution of signs and symptoms of inflammation), or failure (persistency or worsening of signs and symptoms of inflammation), Use of rescue medication during treatment, Safety: Incidence of all Adverse Events (AEs), Adverse Drug Reactions (ADRs), Adverse Events of Special Interest (AESIs) (i.e., AEs related to bleeding, such as bleeding diathesis, namely mucosal bleeding [epistaxis, gum bleeding, menorrhagia] and easy bruising, and GI bleeding), Serious Adverse Events (SAEs), Safety:Frequency of discontinuation of treatment due to AEs, Safety: Changes from baseline at EOT of vital signs (axillary temperature, blood pressure, heart rate and respiratory rate) (in case of on-site EOT visit only), Safety: Physical examination at baseline and EOT (in case of on-site EOT visit only), Safety: Investigator’s and participant’s opinion on drug tolerability at EOT, using a 5-point Likert scale (range 0-4; 0 = poor, 1 = slight, 2 = moderate, 3 = good, 4 = excellent)

Source: https://euclinicaltrials.eu/ctis-public/view/2023-505809-17-00